EU clinical trial 2025-520899-25-00: PILOT STUDY ON THE EFFECTIVENESS OF CHOLINE ALFOSCERATE IN THE UNDER THRESHOLD DEPRESSION OF THE ELDERLY
Protocol code: CARTESIO
Sponsor: Azienda Socio Sanitaria Territoriale Di Lodi (Hospital/Clinic/Other health care facility). Phase: Therapeutic use (Phase IV). Countries: Italy (ongoing, recruiting).
Therapeutic area(s): Psychiatry and Psychology [F] - Mental Disorders [F03]
Gender: Female, Male. Age: 18-64 years, 65+ years. Enrolment: 20.
Status: Ongoing, recruiting. Start date (EU): 2024-05-17. Decision date: 2025-01-31. Results received: No. Last updated: 2025-08-22.

Condition(s): Under threshold depression of the elderly.
Product: GLIATILIN 600 capsule

Primary endpoint: The primary objective will be evaluated through the analysis of the changes at the final visit from the baseline of the following tests: HAMD-17 (Hamilton Depression Rating Scale-17 items).
Endpoint(s): • The depression symptoms associated with subthreshold depression will be evaluated through the analysis of the changes at the final visit from baseline of the following tests: GDS-15 (Geriatric Depression Scale-15 items); CGI-s (Clinical Global Impression-severity). • The cognitive symptoms associated with subthreshold depression will be evaluated through the analysis of the changes at the final visit from baseline of the following tests: MOCA (Montreal Cognitive Assessment) scale.

Source: https://euclinicaltrials.eu/ctis-public/view/2025-520899-25-00